EU clinical trial 2024-517893-73-00: Maternal determinants of infant immunity to pertussis (MADI-02)
Sponsor: Universite Libre de Bruxelles (Educational Institution). Phase: Therapeutic use (Phase IV). Countries: Belgium (ended).
Therapeutic area(s): Diseases [C] - Bacterial Infections and Mycoses [C01]; Diseases [C] - Respiratory Tract Diseases [C08]
Gender: Female, Male. Age: 0-17 years, 18-64 years. Enrolment: 240.
Status: Ended. Start date (EU): 2023-09-09. End date (EU): 2025-12-23. Decision date: 2024-10-16. Results received: Yes. Last updated: 2024-10-16.

Condition(s): Whooping cough
Product: Vaxelis suspension for injection in pre-filled syringe Diphtheria, tetanus, pertussis (acellular, component), hepatitis B (rDNA), poliomyelitis (inactivated), and Haemophilus type b conjugate vaccine (adsorbed)., Triaxis, suspension injectable en seringue préremplie. Vaccin diphtérique, tétanique et coquelucheux (acellulaire) (adsorbé, contenu réduit en antigène(s))

Primary endpoint: The magnitude of the antibody responses to pertussis vaccination
Endpoint(s): Subclass and binding of pertussis-specific antibodies to Fc-receptors, complement and lectin-like receptors post vaccination., Functional antibody profiling post vaccination (including assays covering cytotoxicity, phagocytosis, cytokine production, antigen uptake), Antibody and B cell repertoire post vaccination, The magnitude and quality of Tdap-specific T lymphocytes post vaccination

Source: https://euclinicaltrials.eu/ctis-public/view/2024-517893-73-00